EU clinical trial 2025-523285-25-00: A Phase III Open-label, Randomised, Multicentre Study Comparing AZD0120, a Dual-Targeting Autologous Chimeric Antigen Receptor T-cell (CAR-T) Therapy Directed Against BCMA and CD19, versus Standard Regimens in Participants with Relapsed Refractory Multiple Myeloma (DURGA-4)
Protocol code: D8311C00001
Sponsor: AstraZeneca AB (Pharmaceutical company). Phase: Therapeutic confirmatory (Phase III). Countries: Norway (authorised, recruitment pending), Poland (authorised, recruitment pending), Spain (authorised, recruitment pending), Germany (authorised, recruitment pending), France (authorised, recruitment pending), Italy (authorised, recruitment pending).
Therapeutic area(s): Diseases [C] - Neoplasms [C04]
Gender: Female, Male. Age: 18-64 years, 65+ years. Enrolment: 153.
Status: Authorised, recruitment pending. Decision date: 2026-04-30. Results received: No. Last updated: 2026-08-07.
Decision dates by country: FR: 2026-05-04, IT: 2026-05-04, ES: 2026-05-04, NO: 2026-04-30, PL: 2026-04-30, DE: 2026-05-04

Condition(s): Relapsed or Refractory Multiple Myeloma
Product: Dexamethason 0,5 mg JENAPHARM®, Pomalidomide Zentiva 3 mg hard capsules, Pomalidomide Zentiva 4 mg hard capsules, Dexamethason 4 mg JENAPHARM, Kyprolis 10 mg powder for solution for infusion, Pomalidomide Zentiva 2 mg hard capsules, Dexamethason 1,5 mg JENAPHARM®, Kyprolis 60 mg powder for solution for infusion, AZD0120, Pomalidomide Zentiva 1 mg hard capsules, Bortezomib Hikma 3,5 mg Pulver zur Herstellung einer Injektionslösung, Kyprolis 30 mg powder for solution for infusion, Dexamethason 8 mg JENAPHARM®, DARZALEX 1800 mg solution for injection

Primary endpoint: Arm A and B: PFS: defined as the time from the randomisation until the date of documented disease progression according to IMWG 2016 criteria as assessed by BICR or death due to any cause, whichever occurs first., Arm A and B: MRD negative CR rate at 9 months: defined as the proportion of participants with MRD negative status and have a response of CR or sCR (according to the IMWG2016 criteria) at 9 months (± 3 months) from randomisation before initiation of subsequent anti-myeloma therapy.
Endpoint(s): Arm A and B: OS: defined as time from randomisation until date of death due to any cause, Arm A and B: CRR (CR/sCR rate): defined as the proportion of participants who achieved a best response of CR or better according to IMWG 2016 criteria, as assessed by BICR., Arm A and B: ORR: defined as the proportion of participants who achieved PR or better according to IMWG 2016 criteria, as assessed by BICR., Arm A and B: DoR: defined as the time from first documented confirmed response until date of documented PD per IMWG2016 criteria or death due to any cause, whichever occurs first., Arm A and B: TTR: defined as the time from randomisation until the date of first documented objective response, as assessed per IMWG 2016 criteria., Arm A and B: MRD negative CR rate: defined as the proportion of participants who have MRD negative status and have a response of CR or sCR (according to the IMWG 2016 criteria) at any time after the date of randomisation and before initiation of subsequent therapy., Arm A and B: Rate of sustained MRD negative CR: defined as the proportion of participants who have achieved MRD negative status and have a response of CR or sCR, confirmed minimum 1 year apart without any examination showing MRD positive status in between status assessments., Arm A and B: PFS-2: defined as the time from randomisation to progression on next line of therapy, as assessed by Investigator or death due to any cause., Arm A and B: TFI: defined as the time from last dose of study intervention to the date of the first dose of subsequent anti-myeloma therapy., Arm A and B: Safety will be evaluated in terms of AEs, vital signs, and clinical laboratory results.

Source: https://euclinicaltrials.eu/ctis-public/view/2025-523285-25-00